EU clinical trial 2024-520409-38-00: Safety, Tolerability, Pharmacokinetics, and Pharmacodynamics of Single and Multiple Doses of ANB033
Protocol code: ANB033-101
Sponsor: First Tracks Biotherapeutics Inc. (Pharmaceutical company). Phase: Human Pharmacology (Phase I)- First administration to humans. Countries: Netherlands (ongoing, recruiting), Finland (ongoing, recruiting), Germany (ongoing, recruiting).
Therapeutic area(s): Diseases [C] - Immune System Diseases [C20]
Gender: Female, Male. Age: 18-64 years, 65+ years. Enrolment: 25.
Status: Ongoing, recruiting. Start date (EU): 2025-11-14. Decision date: 2025-07-24. Results received: No. Last updated: 2026-07-01.
Decision dates by country: DE: 2026-01-13, NL: 2025-07-24, FI: 2025-12-18

Condition(s): Celiac disease, Eosinophilic esophagitis (EoE)

Source: https://euclinicaltrials.eu/ctis-public/view/2024-520409-38-00